EU clinical trial 2025-523111-11-00: A Randomized, Double-Blind, Placebo-Controlled, Phase 1 / 2 Trial Evaluating the Safety, Tolerability, Pharmacokinetics, Pharmacodynamics, and Exploratory Efficacy of Single Ascending Doses of TRCN-1023 Administered by Intrathecal Injections to Adult People Living with Amyotrophic Lateral Sclerosis
Protocol code: TRCN-1023-ALS-101
Sponsor: Trace Neuroscience Inc. (Pharmaceutical company). Phase: Phase I and Phase II (Integrated)- Other. Countries: Germany (ongoing, recruiting), Netherlands (ongoing, recruiting).
Therapeutic area(s): Diseases [C] - Musculoskeletal Diseases [C05]
Gender: Female, Male. Age: 18-64 years, 65+ years. Enrolment: 20.
Status: Ongoing, recruiting. Start date (EU): 2026-06-30. Decision date: 2026-06-22. Results received: No. Last updated: 2026-06-24.
Decision dates by country: DE: 2026-06-24, NL: 2026-06-22

Condition(s): Amyotrophic lateral sclerosis
Product: TRCN-1023, artificial cerebral spinal fluid

Primary endpoint: Frequency of adverse events over [CCI] weeks
Endpoint(s): Plasma and CSF TRCN-1023 concentrations, Plasma PK parameters including, but not limited to, time of maximum observed concentration (Tmax), maximum observed concentration (Cmax), and area under the concentration-time curve (AUC) from time zero to the time of the last measurable concentration (AUClast)

Source: https://euclinicaltrials.eu/ctis-public/view/2025-523111-11-00